EU clinical trial 2022-501918-55-00: A Randomized, Double-blind, Placebo-controlled, Dose-finding Study to Evaluate the Safety, Efficacy, Pharmacokinetics, and Pharmacodynamics of ABBV-552 in Participants with Mild Alzheimer's Disease.
Protocol code: M23-515
Sponsor: Abbvie Deutschland GmbH & Co. KG (Pharmaceutical company). Phase: Therapeutic exploratory (Phase II). Countries: Germany (ended), Spain (ended).
Therapeutic area(s): Diseases [C] - Nervous System Diseases [C10]
Gender: Female, Male. Age: 18-64 years, 65+ years. Enrolment: 44.
Status: Ended. Start date (EU): 2023-09-12. End date (EU): 2024-09-05. End date: 2024-09-12. Decision date: 2023-06-27. Results received: Yes. Last updated: 2024-10-03.
Decision dates by country: ES: 2023-07-27, DE: 2023-06-27

Condition(s): Mild Alzheimer's disease
Product: ABBV-552, Placebo for abbv-552 capsules 1mg, 5mg and 10mg, ABBV-552, ABBV-552

Primary endpoint: The primary endpoint is the change from Baseline in the Alzheimer's Disease Assessment Scale-Cognitive Subscale (ADAS-Cog 14) score at Week 12.

Source: https://euclinicaltrials.eu/ctis-public/view/2022-501918-55-00